EU clinical trial 2025-520622-38-00: Personalized antibiotic TREATment for febrile Urinary Tract Infections in children (TREAT-UTI study): multicenter randomized controlled trial
Protocol code: RC 4/24 TREAT-UTI
Sponsor: Istituto Di Ricovero E Cura A Carattere Scientifico Materno Infantile Burlo Garofolo (Hospital/Clinic/Other health care facility). Phase: Therapeutic confirmatory (Phase III). Countries: Italy (authorised, recruitment pending).
Therapeutic area(s): Diseases [C] - Bacterial Infections and Mycoses [C01]; Diseases [C] - Male Urogenital Diseases [C12]; Diseases [C] - Female Urogenital Diseases and Pregnancy Complications [C13]
Gender: Female, Male. Age: 0-17 years. Enrolment: 520.
Status: Authorised, recruitment pending. Decision date: 2026-02-12. Results received: No. Last updated: 2026-02-12.

Condition(s): Urinary Tract Infections
Product: Augmentin Fruit, 400 mg/57 mg/5 ml suukaudse suspensiooni pulber

Primary endpoint: Rate of infection recurrence, defined as the reappearance of signs and symptoms of febrile UTI and positive urine culture within 30 days after the end of antibiotic therapy.
Endpoint(s): 1. Short-term clinical efficacy between the two groups will be evaluated by clinical assessment and urinalysis during the follow-up., 2. The rate of emergence of antibiotic-resistance or opportunistic strains, defined as the presence of positive urinalysis and positive urine culture for a single type of bacterium resistant to amoxicillin and clavulanic acid, after treatment in case of relapse. It will only be evaluated in suspected relapses by carrying out a urine test and urine culture. The bacterial growth will be considered significant if >105 CF/ml (>104 CFU/ml for urine samples collected by bladder catheterization)

Source: https://euclinicaltrials.eu/ctis-public/view/2025-520622-38-00